EU clinical trial 2022-502974-18-00: Impact of rifampicin in treatment outcome of Cutibacterium spp. prosthetic joint infections - RIFACute
Protocol code: 21-APN-02
Sponsor: Centre Hospitalier Universitaire De Nice (Hospital/Clinic/Other health care facility). Phase: Phase II and Phase III (Integrated). Countries: France (ongoing, recruiting).
Therapeutic area(s): Diseases [C] - Bacterial Infections and Mycoses [C01]
Gender: Female, Male. Age: 18-64 years, 65+ years. Enrolment: 235.
Status: Ongoing, recruiting. Start date (EU): 2023-11-27. Decision date: 2023-05-31. Results received: No. Last updated: 2026-01-26.

Condition(s): C. spp. prosthetic joint infection
Product: CLINDAMYCIN, MOXIFLOXACIN, RIMACTAN 300 mg, gélule, Rifadine 300 mg gélules, AMOXICILLIN, DOXYCYCLINE

Primary endpoint: 1. Rate of C. spp. prosthetic joint infections management failure defined by: RELAPSE or NEW INFECTION or EARLY FAILURE, 2. Rate of adverse event linked to rifampicin, classified according to the CTCAE 5.0. The adverse events will be described by frequency and grade, throughout the treatment, with the maximum grade over all cycles used as the summary measure for each patient.
Endpoint(s): 1. Rate of C. spp. prosthetic joint infections probable failure suspected in case of specific clinical signs (fistula) and/or inflammatory synovial fluid without microbiological positive results and/or histopathological results after revision without microbiological positive results during the 24 months of follow-up, 2. Rate of C. spp. prosthetic joint infections management failure (as defined for the primary endpoint) during the 24 months of follow-up according to the two usable companions in the trial (amoxicillin and moxifloxacin)., Rate of C. spp. prosthetic joint infections management failure (as defined for the primary end-point) during the 12 months of follow-up

Source: https://euclinicaltrials.eu/ctis-public/view/2022-502974-18-00